EU clinical trial 2023-507214-28-00: Network pharmacology-based personalized drug repurposing in thyroid carcinoma: a pilot feasibility trial
Protocol code: R0006692B
Sponsor: Stichting Radboud University Medical Center (Hospital/Clinic/Other health care facility). Phase: Human Pharmacology (Phase I)- Other. Countries: Netherlands (authorised, recruitment pending).
Therapeutic area(s): Diseases [C] - Neoplasms [C04]
Gender: Female, Male. Age: 18-64 years, 65+ years. Enrolment: 10.
Status: Authorised, recruitment pending. Decision date: 2026-07-02. Results received: No. Last updated: 2026-07-22.
Decision dates by country: NL: 2026-07-22

Condition(s): Advanced thyroid cancer

Source: https://euclinicaltrials.eu/ctis-public/view/2023-507214-28-00